EU clinical trial 2024-515150-24-00: A Phase 1 Study on the effects of LY3410738 (study drug) administered to Patients with Advanced Solid Tumors with IDH1 or IDH2 Mutations
Sponsor: Eli Lilly & Co. (Pharmaceutical company). Phase: Human Pharmacology (Phase I)- First administration to humans. Countries: France (ongoing, recruitment ended), Spain (ongoing, recruitment ended).
Therapeutic area(s): Diseases [C] - Neoplasms [C04]
Gender: Female, Male. Age: 18-64 years, 65+ years. Enrolment: 3.
Status: Ongoing, recruitment ended. Start date (EU): 2021-01-19. Decision date: 2024-10-29. Results received: No. Last updated: 2026-01-20.
Decision dates by country: FR: 2024-10-29, ES: 2024-10-31

Condition(s): Patients with IDH1 R132, IDH2 R140 or IDH2 R172-mutant advanced solid tumor types, including but not limited to cholangiocarcinoma, chondrosarcoma, and glioma.

Source: https://euclinicaltrials.eu/ctis-public/view/2024-515150-24-00